EU clinical trial 2023-507836-19-00: Phase I dose escalation study of DPPG2-TSL-DOX combined with hyperthermia in soft tissue sarcoma
Protocol code: TS-DM-STS-101
Sponsor: Thermosome GmbH (Pharmaceutical company). Phase: Human Pharmacology (Phase I)- First administration to humans. Countries: Germany (ended).
Therapeutic area(s): Diseases [C] - Neoplasms [C04]
Gender: Female, Male. Age: 18-64 years, 65+ years. Enrolment: 18.
Status: Ended. Start date (EU): 2023-04-03. End date (EU): 2025-05-28. Decision date: 2024-09-20. Results received: No. Last updated: 2025-07-17.

Condition(s): Locally advanced (unresectable) or metastatic soft tissue sarcoma

Source: https://euclinicaltrials.eu/ctis-public/view/2023-507836-19-00